EU clinical trial 2023-503742-31-00: A study to investigate the effect of ASTX660 (tolinapant) on the pharmacokinetics of substrates of OCT1, OCT2, and MATE1 in healthy volunteers
Protocol code: ASTX660-14
Sponsor: Taiho Oncology Inc. (Pharmaceutical company). Phase: Human Pharmacology (Phase I)- Other. Countries: Germany (ended).
Therapeutic area(s): Not possible to specify
Gender: Female, Male. Age: 18-64 years, 65+ years. Enrolment: 40.
Status: Ended. Start date (EU): 2023-10-23. End date (EU): 2023-12-22. End date: 2023-12-23. Decision date: 2023-10-23. Results received: No. Last updated: 2024-11-22.

Condition(s): Not applicable. Healthy Volunteers

Source: https://euclinicaltrials.eu/ctis-public/view/2023-503742-31-00